EU clinical trial 2026-525162-21-00: A Phase 2a, multi centric, open label clinical study to explore the safety and tolerability, the pharmacokinetics and pharmacodynamics profile and first signs of efficacy of PTI5803 administered as adjunctive therapy with a 3-dose escalation regimen in patients >= 14 years of age with drug-resistant seizures associated to focal cortical dysplasia, followed by an optional open-label extension study.
Protocol code: A_CL_002
Sponsor: PannTheraPi (Pharmaceutical company). Phase: Therapeutic exploratory (Phase II). Countries: France (authorised, recruitment pending).
Therapeutic area(s): Diseases [C] - Nervous System Diseases [C10]
Gender: Female, Male. Age: 0-17 years, 18-64 years. Enrolment: 15.
Status: Authorised, recruitment pending. Decision date: 2026-07-20. Results received: No. Last updated: 2026-07-20.

Condition(s): Drug resistant seizures associated to Focal Cortical Dysplasia
Product: PTI5803

Primary endpoint: Severity and frequency of TEAEs, SAES all along the study, Clinically significant changes in vital signs, clinical laboratory findings, physical examination or 12-lead ECG compared to baseline., Increase in suicide risk as assessed by the C-SSRS compared to baseline., Potential effect on the level of concomitant antiseizure medications (ASMs), as assessed by plasma concentration changes compared to Baseline.
Endpoint(s): Plasmatic concentration of probenecid following multiple doses administrated in patients at 3 different doses-regimen., Comparison of scores between baseline and after each PTI5803 dose for: QOLIE-31 for adults and QOLIE-AD-41 for adolescents, CGI-S, PGI-S, CGI-C, PGI-C; BDI-II., Efficacy of probenecid on seizure frequency reduction, during 28±7 days periods, as compared to the 28 days baseline period, at each dose: 1) mean percentage change of seizure frequency, 2) proportion of subjects experiencing ≥50% and ≥75% reduction of seizure frequency, 3) proportion of patients free of seizures, 4) mean frequency of bilateral tonic-clonic seizure., Questionnaire evaluating the usability of the dosing device.

Source: https://euclinicaltrials.eu/ctis-public/view/2026-525162-21-00